EU clinical trial 2025-521841-26-00: Inhibiting the anti-apoptotic factor, BCL-2, at the time of ART initiation to promote apoptosis of HIV-infected cells and restrict the seeding of the HIV reservoir: An investigator-initiated randomised, controlled, open-label clinical trial (The INITIATE Study)
Protocol code: INITIATE-001
Sponsor: Region Midtjylland (Hospital/Clinic/Other health care facility). Phase: Phase I and Phase II (Integrated)- Other. Countries: Denmark (ongoing, recruiting), Spain (ongoing, recruiting).
Therapeutic area(s): Diseases [C] - Virus Diseases [C02]
Gender: Female, Male. Age: 18-64 years, 65+ years. Enrolment: 38.
Status: Ongoing, recruiting. Start date (EU): 2026-02-20. Decision date: 2026-01-02. Results received: No. Last updated: 2026-01-12.
Decision dates by country: DK: 2026-01-12, ES: 2026-01-02

Condition(s): HIV-1 infection
Product: Venclyxto 100 mg film-coated tablets

Primary endpoint: Primary safety endpoint: Safety defined as treatment-emerging adverse events (AEs) related to study treatment (from Day 0 to Day 365), Primary effect endpoint: The frequency of peripheral blood CD4+ T cells containing intact HIV-DNA at day 365 using the Cross-Subtype Intact Proviral DNA Assay (IPDA)
Endpoint(s): Safety defined as all other treatment-emerging AEs, graded according to severity and assessed as either not related or related to study treatment (from Day 0 to Day 365), Decay rates of plasma HIV RNA following initiation of ART, Levels of CD4+ T cells expressing intracellular p24 quantified by flow cytometry, The frequency of peripheral blood CD4+ T cells containing total HIV-DNA using real-time or digital droplet PCR, The proportion of cells containing constitutive and inducible cell-associated multiply spliced HIV RNA (MS HIV-RNA) at day 365 using the tat/rev induced limiting dilution assay (TILDA), The level of cell-associated unspliced HIV RNA (CA-US HIV RNA) in peripheral blood CD4+ T cells using real-time or digital droplet PCR, Changes in numbers and proportions of B cells, total lymphocytes, CD8+ T cells and CD4+ T cells including memory subsets (from Day 0 to Day 365), The ratio of intact and total HIV-DNA in peripheral blood CD4+ T cells (from Day 0 to Day 365)

Source: https://euclinicaltrials.eu/ctis-public/view/2025-521841-26-00